EU clinical trial 2024-513809-31-00: Evaluation of the hemodynamic tolerance of potassium canrenoate in brain-dead organ donors: randomized controlled clinical trial "CANREO-PMO"
Protocol code: 2019PI117
Sponsor: CHRU De Nancy (Hospital/Clinic/Other health care facility). Phase: Therapeutic exploratory (Phase II). Countries: France (ongoing, recruiting).
Therapeutic area(s): Diseases [C] - Cardiovascular Diseases [C14]; Phenomena and Processes [G] - Circulatory and Respiratory Physiological Phenomena [G09]
Gender: Female, Male. Age: 18-64 years, 65+ years. Enrolment: 36.
Status: Ongoing, recruiting. Start date (EU): 2024-08-27. Decision date: 2024-08-27. Results received: No. Last updated: 2024-08-27.

Condition(s): Brain-dead Organ Donors
Product: SOLUDACTONE 200 mg, lyophilisat et solution pour usage parentéral, CHLORURE DE SODIUM 0,9 % BAXTER, solution pour perfusion en poche

Primary endpoint: Hierarchical composite of events including in descending order:A. Cardio circulatory arrest before organ removal, B. the inability to perform the renal swab (since the anticipated effectiveness of the canrenoate would mainly relate to this organ), C. the average hourly dose of noradrenaline / adrenaline between randomisation and departure to the operating room, D. the average hourly volume of crystalloids and / or colloids used between randomization and departure to the operating room.
Endpoint(s): Secondary objectifs will be evaluated by consulting data from the CRISTAL database : Objective 1 : the vital status and serum creatinine (in μmol / L) with estimation of the glomerular filtration rate (GFR) according to CKD-EPI (in mL / min / 1.73m2), 3 months after kidney transplant,, Objective 2 : The percentage of patients dependent on dialysis and / or with an estimated GFR <20 mL / min / 1.73m² at 3 months, Objective 3 : The vital status of kidney recipients from these donors at 3 months, Objective 4 : The vital status of kidney recipients from these donors and serum creatinine (in μmol / L) with estimation of the glomerular filtration rate (GFR) according to CKD-EPI (in mL / min / 1.73m2), 1 year, 3 years, and 10 years from transplant.

Source: https://euclinicaltrials.eu/ctis-public/view/2024-513809-31-00